EU clinical trial 2023-504625-39-00: An Open-Label, Nonrandomized, Multicenter Extension Study to Evaluate the Long-term Safety and Efficacy of Pegcetacoplan in Participants With C3 Glomerulopathy or Immune-Complex Membranoproliferative Glomerulonephritis (VALE)
Protocol code: APL2-C3G-314
Sponsor: Apellis Pharmaceuticals Inc. (Pharmaceutical company). Phase: Therapeutic confirmatory (Phase III). Countries: Spain (ongoing, recruitment ended), Italy (ongoing, recruitment ended), Czechia (ongoing, recruitment ended), France (ongoing, recruitment ended), Netherlands (ongoing, recruitment ended), Belgium (ended), Austria (ended), Germany (ongoing, recruitment ended).
Therapeutic area(s): Diseases [C] - Immune System Diseases [C20]
Gender: Female, Male. Age: 0-17 years, 18-64 years, 65+ years. Enrolment: 66.
Start date (EU): 2023-05-18. Decision date: 2023-08-31. Results received: No. Last updated: 2026-01-08.
Decision dates by country: BE: 2023-11-21, NL: 2023-11-14, CZ: 2023-08-31, DE: 2024-10-15, ES: 2023-09-01, FR: 2023-11-23, IT: 2023-09-07, AT: 2024-11-04

Condition(s): C3 glomerulopathy (C3G) or immune complex membranoproliferative glomerulonephritis (IC-MPGN)
Product: ASPAVELI 1 080 mg solution for infusion, Nimenrix powder and solvent for solution for injection in vials Meningococcal groups A, C, W-135 and Y conjugate vaccine, PNEUMOVAX 23 Solución inyectable en vial Vacuna antineumocócica de polisacáridos, PNEUMOVAX soluzione iniettabile in siringa preriempita Vaccino pneumococcico polisaccaridico, Bexsero suspension for injection in pre-filled syringe Meningococcal group B Vaccine (rDNA, component, adsorbed), Pneumovax 23 injekční roztok v předplněné injekční stříkačce pneumokoková polysacharidová vakcína

Primary endpoint: The log-transformed ratio of urine protein-to-creatinine ratio (uPCR) over time compared to pretreatment baseline.
Endpoint(s): The proportion of participants with estimated glomerular filtration rate (eGFR) values that are stable or improved from pretreatment values over time., The proportion of participants achieving proteinuria <1 g/day over time., Change from pretreatment in the Functional Assessment of Chronic Illness Therapy–Fatigue (FACIT-Fatigue) Scale score., Change from pretreatment in eGFR values over time., For participants with pretreatment serum albumin levels below the lower limit of normal (LLN), the proportion of participants with normalization of serum albumin levels over time, For participants with pretreatment serum C3 levels below the LLN, the proportion of participant s with normalization of serum C3 levels over time., The proportion of participants with progression to a clinical composite outcome (at least one of the following: doubling of serum creatinine, progression to chronic kidney disease stage 5 or ESRD, renal transplantation, or death) over time.

Source: https://euclinicaltrials.eu/ctis-public/view/2023-504625-39-00